EU clinical trial 2024-511789-35-00: STunning in Acute Myocardial Infarction – Beta blockers, Angiotensin converting enzyme inhibitors and Sodium/glucose cotransporter 2 inhibitors trial (STAMI-BAS)
Sponsor: Vaestra Goetalandsregionen, University Of Gothenburg (Hospital/Clinic/Other health care facility, Educational Institution). Phase: Therapeutic use (Phase IV). Countries: Sweden (ongoing, recruiting).
Therapeutic area(s): Diseases [C] - Cardiovascular Diseases [C14]
Gender: Female, Male. Age: 18-64 years, 65+ years. Enrolment: 120.
Status: Ongoing, recruiting. Start date (EU): 2025-01-05. Decision date: 2024-06-27. Results received: No. Last updated: 2024-06-27.

Condition(s): Myocardial ischemia Myocardial infarction
Product: RAMIPRIL, BISOPROLOL, DAPAGLIFLOZIN

Primary endpoint: Global longitudinal strain (GLS, %) at day 7±24 hours after PCI, adjusted for baseline (day 0) GLS.
Endpoint(s): Left ventricular ejection fraction (LVEF), adjusted for baseline LVEF, NT-proBNP on day 7, adjusted for baseline NT-proBNP, Area under the curve of cardiac troponin-T at day 30, Area under the curve of cardiac troponin-I at day 30, Infarct size at 30 days (assessed by cardiac magnetic resonance imaging [CMRI])

Source: https://euclinicaltrials.eu/ctis-public/view/2024-511789-35-00